EU clinical trial 2023-508741-40-00: EORTC 2029-LCG: Immunotherapy Consolidation After Radical treatment of de-novo Oligo-metaStatic NSCLC: ICARS
Protocol code: EORTC 2029-LCG
Sponsor: European Organisation For Research And Treatment Of Cancer (Patient organisation/association). Phase: Phase II and Phase III (Integrated). Countries: Spain (ended), Belgium (ongoing, recruitment ended), France (ongoing, recruitment ended), Italy (ended), Netherlands (ongoing, recruitment ended).
Therapeutic area(s): Diseases [C] - Neoplasms [C04]
Gender: Female, Male. Age: 18-64 years, 65+ years. Enrolment: 142.
Start date (EU): 2025-01-14. Decision date: 2024-10-07. Results received: No. Last updated: 2026-06-12.
Decision dates by country: ES: 2024-10-08, IT: 2024-10-11, NL: 2024-10-07, BE: 2024-10-09, FR: 2024-10-08

Condition(s): Non-small cell lung cancer
Product: CEMIPLIMAB, Placebo

Primary endpoint: Progression Free Survival according to RECIST 1.1
Endpoint(s): Overall survival, Time to disease progression, Time to development of new metastatic lesions, Time to progression in oligometastatic lesions initially present at registration, AEs according to NCI-CTCAE v5.0 and SAEs, Patient-reported symptoms and treatment side-effects as measured by the EORTC QLQ-C30 and IL316 questionnaires.

Source: https://euclinicaltrials.eu/ctis-public/view/2023-508741-40-00